EU clinical trial 2024-516474-30-00: A Phase Ib, Multicentre, Randomised, Single-blind, Parallel-group, Placebo-controlled, Study to Characterise the Pharmacokinetics and Pharmacodynamics of AZD4604 Administered via the Turbuhaler® Device in Adults with Mild Asthma
Protocol code: D8210C00006
Sponsor: AstraZeneca AB (Pharmaceutical company). Phase: Human Pharmacology (Phase I)- Other. Countries: Germany (ended).
Therapeutic area(s): Diseases [C] - Respiratory Tract Diseases [C08]
Gender: Female, Male. Age: 18-64 years. Enrolment: 16.
Status: Ended. Start date (EU): 2025-02-19. End date (EU): 2025-05-09. End date: 2025-05-29. Decision date: 2024-11-21. Results received: No. Last updated: 2024-11-21.

Condition(s): Asthma

Source: https://euclinicaltrials.eu/ctis-public/view/2024-516474-30-00